EU clinical trial 2024-515768-30-01: DUMELEP trial - Durvalumab (MEDI4736)/Tremelimumab in neoadjuvant and adjuvant setting in patients with HCC treated by percutaneous ablation procedure in curative intent
Protocol code: APHP220729
Sponsor: Assistance Publique Hopitaux De Paris (Hospital/Clinic/Other health care facility). Phase: Therapeutic exploratory (Phase II). Countries: France (ongoing, recruiting).
Therapeutic area(s): Analytical, Diagnostic and Therapeutic Techniques and Equipment [E] - Therapeutics [E02]
Gender: Female, Male. Age: 18-64 years, 65+ years. Enrolment: 30.
Status: Ongoing, recruiting. Start date (EU): 2024-03-28. Decision date: 2024-10-21. Results received: No. Last updated: 2026-05-22.

Condition(s): Hepatocellular carcinoma
Product: IMFINZI 50 mg/mL concentrate for solution for infusion., TREMELIMUMAB

Primary endpoint: One-year local recurrence-free survival
Endpoint(s): In neoadjuvant phase: changes of tumorous and non-tumorous perfusion parameters observed with CT scan/MRI after one months of neoadjuvant treatment (rates of nodule(s) comprising necrosis and/or hypoperfusion radiological aspect compared before and after neoadjuvant course): analyzed as qualitative variables, In neoadjuvant phase: changes of size of nodules following neoadjuvant course, Nodule rates of early response after a single procedure of PA (defined as absence of active tumor evaluated at one month following PA), Incidences of intra segmental/ extra segmental distant recurrence, One-year Overall survival defined as patients who are alive with or without HCC recurrence 1 year after PA procedure. Causes and date of death will be specified when applicable during this timeframe., Treatment-related adverse events will be monitored according to manufacturer guidelines and recommendation, Timeframe of PA performance defined as number of days of delay in case of safety issues encountered during neo-adjuvant phase, Compliance to neoadjuvant and adjuvant treatments: respect of scheduled Durvalumab/Tremelimumab infusions, Frequency of SAEs and discontinuations due to AEs, For biomarkers studies, assessment of tumour architecture and cytology from inclusion to Percutaneous Ablation procedure; assessed up to 30 days: absence of tumour cells (binary scale :0/1), For biomarkers studies, assessment of tumour architecture and cytology from inclusion to Percutaneous Ablation procedure; assessed up to 30 days: assessment of intra and extra tumoral inflammatory infiltrate (semi quantitative scale: 0=non, 1=mild, 2=intense), For biomarkers studies, assessment Gene expression from inclusion to Percutaneous Ablation procedure; assessed up to 30 days: change in gene expression following sequential whole exome sequencing (binary scale 0/1 with clustering analyses)

Source: https://euclinicaltrials.eu/ctis-public/view/2024-515768-30-01